EU clinical trial 2024-518217-26-00: A randomized, phase IIb study of adjuvant durvalumab (MEDI4736) plus regorafenib vs untreated control in stage IV colorectal cancer patients with no evidence of disease (NED): VIVA trial
Protocol code: VIVA
Sponsor: IRCCS Ospedale Policlinico San Martino (Hospital/Clinic/Other health care facility). Phase: Therapeutic exploratory (Phase II). Countries: Italy (ongoing, recruitment ended).
Therapeutic area(s): Diseases [C] - Neoplasms [C04]
Gender: Female, Male. Age: 18-64 years, 65+ years. Enrolment: 182.
Status: Ongoing, recruitment ended. Start date (EU): 2021-10-20. Decision date: 2024-10-28. Results received: No. Last updated: 2024-10-28.

Condition(s): Stage IV colorectal cancer patients with no evidence of disease (NED)
Product: BAY 734506, IMFINZI 50 mg/mL concentrate for solution for infusion.

Primary endpoint: Disease-Free Survival (DFS)
Endpoint(s): ● 18-months Disease-Free Survival (DFS), ● Adverse events and Toxicity, ● Overall Survival (OS), ● Compliance to the experimental treatment

Source: https://euclinicaltrials.eu/ctis-public/view/2024-518217-26-00